EU clinical trial 2024-513972-16-00: Phase III randomized trial comparating concomittant administration of radiotherapy with cisplatin versus radiotherapy only for treatment of sinuses tumors and salivary glands (SANTAL)
Protocol code: GORTEC 2016-02
Sponsor: Groupe Oncologie Radiotherapie Tete Cou (Patient organisation/association). Phase: Therapeutic confirmatory (Phase III). Countries: Belgium (ongoing, recruitment ended), France (ongoing, recruitment ended).
Therapeutic area(s): Diseases [C] - Neoplasms [C04]
Gender: Female, Male. Age: 18-64 years, 65+ years. Enrolment: 342.
Status: Ongoing, recruitment ended. Start date (EU): 2017-01-30. Decision date: 2024-08-28. Results received: No. Last updated: 2025-06-20.
Decision dates by country: FR: 2024-09-16, BE: 2024-08-28

Condition(s): - Resected tumors of sinuses or salivary glands; - Non-operable tumors of sinuses or salivary glands; - Carcinomas of major salivary glands; - Malignant tumors of sinuses
Product: Cisplatin 1 mg/ml Concentrate for Solution for Infusion

Primary endpoint: Progression-free survival
Endpoint(s): Overall survival, Quality of life, Time to locoregional progression, Time to distance progression, Rate of acute toxicity grade ≥ 3, Rate of late toxicities of grade ≥ 3, Prognostic criteria

Source: https://euclinicaltrials.eu/ctis-public/view/2024-513972-16-00